EU clinical trial 2024-516263-92-00: A Phase 3, Randomized, Open-Label, Multicenter Study to Evaluate the Safety (Compared to Iron Sucrose), Efficacy and Pharmacokinetics of Ferumoxytol for the Treatment of Iron Deficiency Anemia (IDA) in Pediatrics Subjects with Chronic Kidney Disease (CKD)
Protocol code: AMAG-FER-CKD-354
Sponsor: Amag Pharmaceuticals Inc. (Pharmaceutical company). Phase: Therapeutic confirmatory (Phase III). Countries: Lithuania (ongoing, recruiting), Hungary (ended), Poland (ended).
Therapeutic area(s): Diseases [C] - Nutritional and Metabolic Diseases [C18]
Gender: Female, Male. Age: 0-17 years. Enrolment: 25.
Start date (EU): 2018-06-25. Decision date: 2024-09-05. Results received: No. Last updated: 2025-06-30.
Decision dates by country: HU: 2024-09-05, PL: 2024-10-05, LT: 2024-09-06

Condition(s): Iron Deficiency Anemia (IDA) in Pediatric Subjects with Chronic Kidney Disease (CKD)
Product: Venofer 20 mg iron / ml, solution for injection or concentrate for solution for infusion., Ferumoxytol

Primary endpoint: Efficacy Endpoints: Primary endpoint: Proportion of patients achieving a hemoglobin increase of at least 0.5 g/dL during the period from Baseline to Week 5., Proportion of patients achieving a hemoglobin increase of at least 0.5 g/dL or TSAT increase of at least 10% during the period from Baseline to Week 5., Proportion of patients achieving a TSAT increase of at least 10% during the period from Baseline to Week 5., Change in hemoglobin from Baseline to Week 5., Whether or not the subject had an increase in hemoglobin ≥1.0 g/dL during the period from Baseline to Week 5., Change in TSAT from Baseline to Week 5., Whether or not the subject required initiation of ESA or a >20% increase in dose during the study., Whether or not the subject received blood transfusions during the study., Change in other markers of iron stores (e.g., serum ferritin and serum iron) from Baseline to Week 5., Safety Endpoints: Incidence of adverse events of special interest (AESI) (hypotension and hypersensitivity)., Incidence of SAEs., Incidence of Severe AEs., Incidence of Cardiovascular AEs (myocardial infarction, heart failure, moderate to severe hypertension, and hospitalization due to any cardiovascular cause)., Incidence of AEs leading to study drug discontinuation., Incidence of treatment emergent AEs., Change in vital signs (blood pressure, heart rate, respiration rate) and body temperature, and routine laboratory parameters (hematology, chemistry, and iron panel).
Endpoint(s): Pharmacokinetic Endpoints: Area Under the Curve (AUC)., Clearance, Distribution and elimination half-lives.

Source: https://euclinicaltrials.eu/ctis-public/view/2024-516263-92-00